EU clinical trial 2025-523654-13-00: A multicentre, randomized, double-blind, placebo-controlled phase II/III trial investigating the efficacy of anti-FcRn targeting with efgartigimod as a first-line add-on therapy to IVMP in moderate-to-severe attacks of demyelinating diseases of the central nervous system
Sponsor: Medizinische Hochschule Hannover (Educational Institution). Phase: Phase II and Phase III (Integrated). Countries: Germany (authorised, recruitment pending), Austria (authorised, recruitment pending).
Therapeutic area(s): Diseases [C] - Nervous System Diseases [C10]
Gender: Female, Male. Age: 18-64 years, 65+ years. Enrolment: 116.
Status: Authorised, recruitment pending. Decision date: 2026-06-17. Results received: No. Last updated: 2026-06-21.
Decision dates by country: AT: 2026-06-21, DE: 2026-06-17

Condition(s): Demyelinating diseases
Product: n/a, EFGARTIGIMOD ALFA

Primary endpoint: The proportion of patients who achieve complete remission of TNDs by day 84* after the first IMP administration without rescue attack therapy. Complete remission is defined as a return to at least pre-attack levels in all TNDs FSS and HCVA
Endpoint(s): 1. Proportion of patients not requiring rescue attack therapy (plasmapheresis (PLEX), immunoadsorption (IA)) by day 28 after first IMP administration, 2. Proportion of patients achieving complete remission of TNDs at day 10 and 28 without rescue attack therapy, 3. Proportion of patients achieving almost complete remission of TNDs by day 84* without rescue attack therapy; * Complete or almost complete remission can be achieved at another visit prior to day 84, 4. Proportion of patients achieving almost complete remission of TNDs (according to Appendix 1) at day 10 and 28 without rescue attack therapy, 5. Change in attack-affected neurological function scores from baseline at day 10, 28, and 84, including: ○ Overall EDSS (Expanded Disability Status Scale) ○ Main TND FSS‡‡ ○ Ambulation score ○ Habitual corrected high-contrast visual acuity (HCVA) ○ Nine-Hole Peg Test (9HPT) ○ Timed 25-Foot Walk (T25FW), 6. Best-corrected high-contrast visual acuity (HCVA) and habitual corrected low-contrast visual acuity (LCVA) at day 28, 84, 7. Early relapses rates within 3 months (day 84), 8. Change from baseline in quality-of-life scores at day 28 and 84, including: ○ General quality of life (EQ-5D) ○ Vision-related quality of life (NEI VFQ-25) if ON attack, 9. Change from baseline in immunological and neurodegenerative biomarkers at day 4, 10, 21, 28 and 84 post-treatment, including: ○ Total IgG and IgG subclasses (IgG1–4) ○ AQP4-IgG and MOG-IgG titers ○ Neurofilament light chain (NfL) ○ Glial fibrillary acidic protein (GFAP), 10. Change from baseline in immunological biomarkers at day 4, 10 post-treatment, including: ○ Complement proteins (C3, C4), 11. Cumulative dosage of IVMP at day 84, Assessment of safety: Incidence rates of adverse events (AEs), serious adverse events (SAEs) and adverse event of special interest (AESIs) by day 28 after treatment onset and during the complete trial

Source: https://euclinicaltrials.eu/ctis-public/view/2025-523654-13-00